EU clinical trial 2026-525930-47-00: Pilot, randomized, crossover, comparative bioavailability study of two tadalafil formulations (oral suspension and film-coated tablets) after a single oral dose of 20 mg under fasting conditions in healthy male volunteers.
Protocol code: FMLD-TALLIN-69_FIP-A
Sponsor: Farmalider S.A. (Pharmaceutical company). Phase: Human Pharmacology (Phase I)- Other. Countries: Spain (ended).
Therapeutic area(s): Not possible to specify
Gender: Male. Age: 18-64 years. Enrolment: 8.
Status: Ended. Start date (EU): 2026-05-07. End date (EU): 2026-06-11. Decision date: 2026-04-29. Results received: No. Last updated: 2026-04-30.
Decision dates by country: ES: 2026-04-30

Condition(s): Healthy volunteers

Source: https://euclinicaltrials.eu/ctis-public/view/2026-525930-47-00